EU clinical trial 2023-506348-17-00: A single-arm, multi-center, open-label Phase II study to determine the safety and efficacy of MB-CART2019.1 in pediatric subjects with relapsed/refractory (r/r) mature B-cell neoplasms who have relapsed after one or more prior therapies, including subjects with primary refractory disease
Protocol code: M-2021-389
Sponsor: Miltenyi Biomedicine GmbH (Pharmaceutical company). Phase: Therapeutic exploratory (Phase II). Countries: Germany (authorised, recruitment pending), France (ongoing, recruiting), Italy (ongoing, recruiting), Netherlands (authorised, recruitment pending).
Therapeutic area(s): Diseases [C] - Neoplasms [C04]
Gender: Female, Male. Age: 0-17 years. Enrolment: 12.
Start date (EU): 2025-07-22. Decision date: 2024-11-05. Results received: No. Last updated: 2026-03-16.
Decision dates by country: DE: 2024-11-06, FR: 2024-11-05, IT: 2024-11-07, NL: 2024-11-05

Condition(s): Relapsed/refractory (r/r) mature B cell neoplasms who have relapsed after one or more prior therapies, including subjects with primary refractory disease
Product: MB-CART2019.1, FLUDARABINE, CYCLOPHOSPHAMIDE, TOCILIZUMAB

Primary endpoint: • Type, frequency, and severity of adverse events (AEs), serious adverse events (SAEs), and adverse events of special interest (AESI). Primary efficacy estimand:, BORR, defined as the proportion of subjects with at least one partial response (PR) or complete response (CR) based on independent review committee (IRC) assessment from MB-CART2019.1 infusion until progressive disease (PD), start of new anti lymphoma therapy, lost to follow-up or death due to any cause, whichever occurs first.
Endpoint(s): Key secondary efficacy endpoints • BORR until Week 24, defined as the proportion of subjects with at least one PR or CR after the MB-CART2019.1 infusion, based on IRC assessment until Week 24., • CRR, defined as the proportion of subjects with at least one CR assessment, based on IRC assessment. ", • DOR, defined as the time between the date of first objective response (CR/PR) until the date of PD, based on IRC assessment, or lost to follow-up, or death due to any cause, whichever occurs first. ", • DOCR, defined as the time between the date of first CR until the date of PD, based on IRC assessment, or lost to follow-up, or death due to any cause, whichever occurs first. ", • TTR, defined as the time between the date of MB-CART2019.1 infusion and the date of a first objective response (CR/PR), based on IRC assessment. ", • TTCR, defined as the time between the date of MB-CART2019.1 infusion and the date of a first objective CR, based on IRC assessment. ", • ORR, defined as the proportion of subjects with a PR or CR, based on IRC assessment, at the following visits: Day 28, Week 8, Week 12, Week 24, Week 52, and Week 78. ", • EFS, defined as the time between the date of the MB-CART2019.1 infusion and the date of an event (PD, start of a new anti-lymphoma therapy after MB-CART2019.1 infusion excluding hematopoietic stem cell transplantation [HSCT], relapse, or death due to any cause), based on IRC assessment. ", • PFS, defined as the time between the date of MB-CART2019.1 infusion and the date of PD based on IRC assessment, or lost to follow-up, or death due to any cause, whichever occurs first. ", • OS, defined as the time between the date of MB-CART2019.1 infusion and the date of death due to any cause, irrespective of new anti-lymphoma therapy. ", • OS rates at Week 52 and at Week 78. ", • BORR, based on investigator assessment. ", • BORR until Week 24, based on investigator assessment. ", • CRR, based on investigator assessment. ", • DOR, based on investigator assessment. ", • DOCR, based on investigator assessment., • TTR, based on investigator assessment. ", • TTCR, based on investigator assessment. ", • ORR, based on investigator assessment, at the following visits: Day 28, Week 8, Week 12, Week 24, Week 52, and Week 78. ", • EFS, based on investigator assessment. ", • PFS, based on investigator assessment., • Occurrence and persistence of B-cell aplasia. ", • The proportion of subjects who proceed to HSCT after MB-CART2019.1 infusion until end of study (EOS). ", • Types and levels of cytokines (including soluble interleukin-2 receptor [sIL-2R], IL-6, IL-10, IL-15, interferon gamma [IFN-γ], and tumor necrosis factor alpha [TNF-α]), • Persistence and phenotype of MB-CART2019.1, based on flow cytometry analyses and persistence based on quantitative polymerase chain reaction (qPCR). ", • Anti-MB-CART2019.1 antibody via anti-drug antibody assay ", • Change from baseline in HRQoL, using the EuroQol-5 Dimensions-Youth (EQ-5D-Y) questionnaire", • Hospital days within 6 months after MB-CART2019.1 infusion. ", • Intensive care unit (ICU) admission days within 6 months after MB-CART2019.1 infusion. ", • Use of tocilizumab and/or high-dose steroids and/or anti-interleukin medication. ", • Need for transfusions, prophylactic antimicrobial therapy, and gamma globulin substitution within 12 months after MB-CART2019.1 infusion., • Change in clinical laboratory assessments, physical and neurological examinations, and electrocardiogram (ECG) parameters within 6 months after MB-CART2019.1 infusion. ", • Monitoring of RCL by qPCR", • CD19/CD20 antigen expression in tumor biopsies in case of relapse after MB-CART2019.1 infusion

Source: https://euclinicaltrials.eu/ctis-public/view/2023-506348-17-00